EU clinical trial 2025-521319-38-00: A phase II, open label, multicenter trial investigating Irinotecan plus cetuximab rechallenge compared with trifluridine/tipiracil plus bevacizumab as third line treatment in circulating tumor DNA molecularly selected metastatic colorectal cancer: the ROMANCE-GOIM trial
Sponsor: Gruppo Oncologico Dell'Italia Meridionale (Patient organisation/association). Phase: Therapeutic exploratory (Phase II). Countries: Italy (ongoing, recruiting).
Therapeutic area(s): Diseases [C] - Neoplasms [C04]
Gender: Female, Male. Age: 18-64 years, 65+ years. Enrolment: 150.
Status: Ongoing, recruiting. Start date (EU): 2026-03-11. Decision date: 2026-01-19. Results received: No. Last updated: 2026-05-25.

Condition(s): metastatic colorectal cancer
Product: BEVACIZUMAB, IRINOTECAN, Lonsurf 20 mg/8.19 mg film-coated tablets, CETUXIMAB

Primary endpoint: ORR by RECIST 1.1 defined as the proportion of patients who have a partial or complete response to therapy. An external radiology department will receive the images of radiological re-evaluations from the participating sites. The imaging will be assessed by a blind operator
Endpoint(s): 1. PFS defined as the time from random assignment in the clinical trial to disease progression or death from any cause., 2. OS defined as the interval from enrollment to death for every cause., 3. The safety profile of the trial drugs as measured by the incidence of AEs evaluated using the NCI- CTCAE version 5.0 (CTCAE v 5.0), SAEs, clinical laboratory assessments, vital signs, physical examination, ECG parameters, and ECOG PS, 4. Quality of life (QoL) questionnaire (EORTC QLQ-C30)

Source: https://euclinicaltrials.eu/ctis-public/view/2025-521319-38-00